EU clinical trial 2024-518030-83-00: A Phase 3, Multicenter, Prospective, Randomized, Double-Masked, Parallel-Group Study of EYP-1901, a Tyrosine Kinase Inhibitor (TKI), Compared to Aflibercept in Subjects with Wet AMD (EYP-1901-302)
Protocol code: EYP-1901-302
Sponsor: Eyepoint Inc. (Pharmaceutical company). Phase: Therapeutic confirmatory (Phase III). Countries: Germany (ongoing, recruitment ended), Czechia (ongoing, recruitment ended), Hungary (ongoing, recruitment ended), Poland (ongoing, recruitment ended), Slovakia (ongoing, recruitment ended).
Therapeutic area(s): Diseases [C] - Eye Diseases [C11]
Gender: Female, Male. Age: 18-64 years, 65+ years. Enrolment: 143.
Status: Ongoing, recruitment ended. Start date (EU): 2025-06-05. Decision date: 2025-05-14. Results received: No. Last updated: 2026-04-30.
Decision dates by country: DE: 2025-05-14, CZ: 2025-05-16, HU: 2025-05-19, SK: 2025-05-19, PL: 2025-05-25

Condition(s): Wet age-related macular degeneration (wAMD)
Product: Eylea 40 mg/mL solution for injection in pre-filled syringe., EYP-1901

Primary endpoint: The primary endpoint of this study is to find out whether EYP-1901 can produce the same vision benefits as aflibercept over 56 weeks.
Endpoint(s): The secondary endpoints of the study are to find out: 1. Total number of supplemental injections of aflibercept needed over the 56 weeks of treatment, 2. Changes in the thickness of the retina (light-sensitive membrane at the back of the eye) from Week 12 through Week 56 of treatment, 3. Number of injections a participant needs up to 96 weeks of treatment, 4. Changes in the retina structure and function over the 96 weeks of treatment

Source: https://euclinicaltrials.eu/ctis-public/view/2024-518030-83-00